EU clinical trial 2024-514556-32-00: Effect of high-dose vitamin D3 on 28-day mortality in adult critically ill patients with severe vitamin D deficiency: a multicenter, placebocontrolled double-blind phase III RCT
Protocol code: The VitDalize Study
Sponsor: Medical University Of Graz (Educational Institution). Phase: Therapeutic confirmatory (Phase III). Countries: Germany (ongoing, recruiting), Austria (ongoing, recruiting).
Therapeutic area(s): Diseases [C] - Nutritional and Metabolic Diseases [C18]
Gender: Female, Male. Age: 18-64 years, 65+ years. Enrolment: 1600.
Status: Ongoing, recruiting. Start date (EU): 2017-02-15. Decision date: 2024-12-11. Results received: No. Last updated: 2025-06-16.
Decision dates by country: AT: 2025-03-11, DE: 2024-12-11

Condition(s): Adult critically ill patients with severe vitamin D deficiency
Product: Oleovit D3 Tropfen, MIGLYOL 812 N

Primary endpoint: 28-day mortality
Endpoint(s): 90-day mortality, 1-year mortality, ICU and hospital mortality, Hospital and ICU length of stay, SOFA Score at day 5 (48 hours tolerance) and number of organ failures (> 2 SOFA points in each of the 6 categories), Katz Activities of Daily Life (ADL) at day 90, Self - reported infections requiring antibiotics until day 90, Hospital and ICU readmission until day 90, Hypercalcemia on day 5 (48 hours tolerance), Self-reported falls, fractures until day 90, New episodes of kidney stones

Source: https://euclinicaltrials.eu/ctis-public/view/2024-514556-32-00